EU clinical trial 2024-516509-22-00: The OPTIMIzE study;OPen label multicenter randomized Trial comparing standard IMmunosuppression with tacrolimus and mycophenolate mofetil with a low exposure tacrolimus regimen In combination with everolimus in de novo renal transplantation in Elderly patients.
Sponsor: Universitair Medisch Centrum Groningen (Hospital/Clinic/Other health care facility). Phase: Therapeutic use (Phase IV). Countries: Netherlands (ended), Belgium (ended).
Therapeutic area(s): Phenomena and Processes [G] - Immune system processes [G12]
Gender: Female, Male. Age: 65+ years. Enrolment: 381.
Status: Ended. Start date (EU): 2019-07-22. End date (EU): 2025-04-14. Decision date: 2024-11-04. Results received: No. Last updated: 2024-11-12.
Decision dates by country: BE: 2024-11-12, NL: 2024-11-04

Condition(s): kidney transplant
Product: Prednisolone 5mg Soluble Tablets, Certican 0,75 mg tablety, Mycofenolaat mofetil Sandoz 250 mg, capsules, hard, Envarsus 0.75 mg prolonged-release tablets, Simulect 20 mg powder and solvent for solution for injection or infusion, Ciclosporine Teva 25 mg, zachte capsules

Primary endpoint: Incidence of individual endpoints of death, graft loss, eGFR below 30 or 45 ml/min/1.73m2 at Months 12 and 24, Incidence of treated biopsy-proven rejection (tBPAR), Rejection treatment and type of rejection treatment, The evolution of renal function (eGFR and creatinine clearance) over time by slope analysis, The incidence of adverse events, serious adverse events and adverse reactions, The incidence of clinically relevant infections, post transplantation diabetes mellitus, malignancies and cardiovascular events, Presence of frailty at 12 and 24 months after transplantation and change in frailty from baseline, Presence of markers for immunosenescence at 12 and 24 months and changes from baseline, HRQoL at 0, 12 and 24 months and changes from baseline, Development of donor-specific anti-HLA antibodies (DSA), Difference in illness perception at 0, 12 and 24 months and changes from baseline, Difference in BAASIS at 12 and 24 months, Difference in symptoms (DSI + MTSOSD-59) at 0, 12 nad 24 months and changes from baseline, Difference in iBOX predicted outcome at 3, 5 and 7 years

Source: https://euclinicaltrials.eu/ctis-public/view/2024-516509-22-00